EU clinical trial 2024-512169-15-00: A Phase 1/2, Multicenter Study Evaluating the Safety, Tolerability, and Biodistribution of RCT2100 with Single-Ascending Doses in Healthy Participants and Multiple-Ascending Doses and Proof-of-Concept in Participants with Cystic Fibrosis
Protocol code: RCT2100-101
Sponsor: Recode Therapeutics Inc. (Pharmaceutical company). Phase: Phase I and Phase II (Integrated)- First administration to humans. Countries: France (ended), Netherlands (ended).
Therapeutic area(s): Diseases [C] - Respiratory Tract Diseases [C08]
Gender: Female, Male. Age: 18-64 years. Enrolment: 17.
Status: Ended. Start date (EU): 2024-08-28. End date (EU): 2026-03-31. Decision date: 2024-07-24. Results received: No. Last updated: 2026-06-26.
Decision dates by country: FR: 2024-07-24, NL: 2024-07-25

Condition(s): Cystic Fibrosis
Product: RCT2100, Kalydeco 150 mg film-coated tablets

Primary endpoint: Safety and tolerability as assessed by number of participants with AEs and SAEs
Endpoint(s): Biodistribution parameters may be derived from concentrations of RCT2100 components in blood (where feasible). Parameters may include but are not limited to the following: AUC, Cmax, Tmax, and t1/2, Absolute change in percent predicted FEV1 (ppFEV1) from baseline to Week 4 (escalation cohorts 1 to 3) or Week 12 (expansion cohort), Change from baseline in CF questionnaire-revised (CFQ-R) respiratory domain score through Week 4 (escalation cohorts 1 to 3) or Week 12 (expansion cohort), Incidence and titer of anti-CFTR binding antibodies, Based on safety and tolerability at projected efficacious doses, Please refer to the protocol for details.

Source: https://euclinicaltrials.eu/ctis-public/view/2024-512169-15-00